EU clinical trial 2023-506688-32-00: A Multicenter Open-label Extension Study to Evaluate the Long-term Safety of Cenobamate Adjunctive Therapy in Subjects with Primary Generalized Tonic-Clonic Seizures
Protocol code: YKP3089C033
Sponsor: Sk Life Science Inc. (Pharmaceutical company). Phase: Therapeutic confirmatory (Phase III). Countries: Germany (ended), Hungary (ended), Spain (ended), Slovakia (ended), Poland (ended).
Therapeutic area(s): Diseases [C] - Nervous System Diseases [C10]
Gender: Female, Male. Age: 0-17 years, 18-64 years, 65+ years. Enrolment: 77.
Status: Ended. Start date (EU): 2019-10-09. End date (EU): 2026-05-27. End date: 2026-06-10. Decision date: 2024-05-10. Results received: No. Last updated: 2025-12-10.
Decision dates by country: DE: 2024-05-14, ES: 2024-05-10, HU: 2024-05-10, PL: 2024-05-16, SK: 2024-05-10

Condition(s): Primary Generalized Tonic-Clonic Seizures
Product: Placebo matching with 12.5mg, 25mg, 50mg, 100mg cenobamate tablets and 10mg/kg cenobamate oral suspension unit strength, Cenobamate 12.5mg, Cenobamate 50mg, Cenobamate 25mg, Cenobamate 100mg, Cenobamate 10mg/mL

Primary endpoint: The primary endpoints are safety measures: the incidences of adverse events (AEs) and serious adverse events (SAEs); summary statistics for clinical laboratory test results and vital signs; and physical examination, neurologic examination, and electrocardiogram (ECG) findings.

Source: https://euclinicaltrials.eu/ctis-public/view/2023-506688-32-00